EU clinical trial 2024-514965-20-00: SEQUence of Endocrine therapy in advanced Luminal Breast cancer (SEQUEL-Breast): A phase 2 study on fulvestrant beyond progression in combination with alpelisib for PIK3CA-mutated, hormone-receptor positive HER2 negative advanced breast cancer
Protocol code: BOOG 2021-01
Sponsor: BOOG Study Center B.V. (Laboratory/Research/Testing facility). Phase: Therapeutic exploratory (Phase II). Countries: Netherlands (ongoing, recruitment ended).
Therapeutic area(s): Diseases [C] - Neoplasms [C04]
Gender: Female, Male. Age: 18-64 years, 65+ years. Enrolment: 130.
Status: Ongoing, recruitment ended. Start date (EU): 2022-06-02. Decision date: 2024-09-11. Results received: No. Last updated: 2024-09-11.

Condition(s): Breast cancer
Product: Piqray 150 mg film-coated tablets, Piqray 200 mg film-coated tablets, Piqray 50 mg and 200 mg film-coated tablets, Piqray 200 mg film-coated tablets, Piqray 150 mg film-coated tablets, Piqray 200 mg film-coated tablets, Piqray 50 mg and 200 mg film-coated tablets, Piqray 50 mg and 200 mg film-coated tablets, Piqray 150 mg film-coated tablets

Primary endpoint: To determine Progression-free survival (PFS), defined as time from study enrollment to disease progression or death from any cause, with censoring when fulvestrant and alpelisib are stopped and another treatment is initiated without confirmed disease progression.
Endpoint(s): To determine Progression-free survival (PFS) 'on treatment' defined as time from study enrollment to disease progression or death from any cause, with censoring when fulvestrant and alpelisib are stopped earlier than disease progression, to determine the Objective Response Rate (CR/PR), to determine the Clinical Benefit Rate (SD/CR/PR), to determine the Duration of Response (DoR), to evaluate safety and tolerability, to determine risk factors for alpelisib-induced hyperglycemia, to determine which management is needed in patients with alpelisib-induced hyperglycemia, and time till resolvement, to assess Quality of Life (QoL), to evaluate Patient Reported Outcome Measures (PROMs), to compare PFS in patients with the 11 most frequent activating PIK3CA mutations with PFS in patients with unselected activating PIK3CA mutations (including rare mutations), to determine Overall Survival (OS), to determine pharmacokinetics of alpelisib

Source: https://euclinicaltrials.eu/ctis-public/view/2024-514965-20-00